EU clinical trial 2022-502694-41-00: WOMEN&More: Prospective phase III multi-center open-label study of the efficacy, safety, and acceptability of mifepristone 50 mg once-weekly as a contraceptive
Sponsor: Leiden University Medical Center (Hospital/Clinic/Other health care facility). Phase: Therapeutic confirmatory (Phase III). Countries: Netherlands (ongoing, recruitment ended).
Therapeutic area(s): Phenomena and Processes [G] - Reproductive and Urinary Physiological Phenomena [G08]
Gender: Female. Age: 18-64 years. Enrolment: 1186.
Status: Ongoing, recruitment ended. Start date (EU): 2025-04-14. Decision date: 2025-02-28. Results received: No. Last updated: 2025-11-07.

Condition(s): Contraception
Product: Mifepristone 50mg

Primary endpoint: Occurrence of pregnancy during treatment caused by user and method failure (Overall Pearl Index)
Endpoint(s): Proportion of participants with endometrial thickness >15 mm, endometrium with irregular cystic appearance on US; with ALT, AST elevation three times above normal levels or bilirubin two times above normal levels; with adverse events / serious adverse events, Acceptability assessment: User failure, Depression, Sexual functioning, Use of antidepressants, Weight changes, Bleeding profile, Side effects, Acceptability, Proportion of participants either opting for an abortion or opting for continuing the pregnancy. In case of continuation: outcomes of pregnancies such as miscarriages, ectopic pregnancies, preterm labor, growth restriction and congenital abnormalities will be registered, Figures about liver functions below 3 x Upper Limit Normal (ULN) (ALT/AST) or below 2 x ULN (bilirubin) are unknown, as time to normalization

Source: https://euclinicaltrials.eu/ctis-public/view/2022-502694-41-00